EU clinical trial 2024-519331-42-00: A Phase 3, Randomized, Open-label, Multicenter Study to Compare the Efficacy and Safety of Sacituzumab Tirumotecan in Combination with Pembrolizumab Versus Pembrolizumab Alone as First-line Maintenance Treatment in Participants with Mismatch Repair Proficient Endometrial Cancer (TroFuse-033/GOG-3119/ENGOT-en29)
Protocol code: MK-2870-033
Sponsor: Merck Sharp & Dohme LLC (Pharmaceutical company). Phase: Therapeutic confirmatory (Phase III). Countries: Netherlands (ongoing, recruiting), Greece (ongoing, recruiting), Denmark (ongoing, recruiting), Poland (ongoing, recruiting), Spain (ongoing, recruiting), Italy (ongoing, recruiting), Norway (ongoing, recruiting), Germany (ongoing, recruiting), Hungary (ongoing, recruiting), Belgium (ongoing, recruiting), Finland (ongoing, recruiting), Sweden (ongoing, recruiting), Austria (ongoing, recruiting), Ireland (ongoing, recruiting), France (ongoing, recruiting), Czechia (ongoing, recruiting).
Therapeutic area(s): Diseases [C] - Neoplasms [C04]
Gender: Female. Age: 18-64 years, 65+ years. Enrolment: 371.
Status: Ongoing, recruiting. Start date (EU): 2025-08-22. Decision date: 2025-06-24. Results received: No. Last updated: 2026-07-21.
Decision dates by country: DK: 2025-06-24, SE: 2025-07-31, NO: 2025-06-30, IT: 2025-06-30, PL: 2025-06-30, NL: 2025-07-01, HU: 2025-07-02, IE: 2025-06-27, FR: 2025-06-25, BE: 2025-07-07, AT: 2025-06-30, CZ: 2025-07-07, FI: 2025-06-30, GR: 2025-06-27, ES: 2025-07-01, DE: 2025-07-01

Condition(s): pMMR endometrial carcinoma
Product: PACLITAXEL, PARACETAMOL, MK-2870, CARBOPLATIN, CIMETIDINE, KEYTRUDA 25 mg/mL concentrate for solution for infusion, DOCETAXEL, MK-2870

Primary endpoint: Maintenance Treatment: Progression Free Survival (PFS), Maintenance Treatment: Overall Survival (OS)
Endpoint(s): Maintenance Treatment: Progression-Free Survival 2 (PFS2) as Assessed by Investigator, Maintenance Treatment: Number of Participants Who Experience One or More Adverse Events (AEs), Maintenance Treatment: Number of Participants Who Discontinue Study Intervention Due to an AE, Maintenance Treatment: Change from baseline in European Organization for the Research and Treatment of Cancer Quality of Life Questionnaire Core 30 (EORTC QLQ-C30) Global Health Status (Item 29) and Quality of Life (Item 30) Item Mean Score, Maintenance Treatment: Change from baseline in EORTC QLQ-C30 Physical Functioning (Items 1-5) Combined Score, Maintenance Treatment: Change from baseline in EORTC QLQ-C30 Role Functioning (Items 6 and 7) Combined Score, Maintenance Treatment: Change from baseline in EORTC QLQ Endometrial Cancer Symptom Score (QLQ-EN24)

Source: https://euclinicaltrials.eu/ctis-public/view/2024-519331-42-00